EU clinical trial 2024-511140-37-00: Stereotactic body radiotherapy with or without Darolutamide for OligoRecurrent prostate cancer: a randomized phase II trial (DART).
Protocol code: DART
Sponsor: Universitair Ziekenhuis Gent (Hospital/Clinic/Other health care facility). Phase: Therapeutic exploratory (Phase II). Countries: Belgium (ended).
Therapeutic area(s): Diseases [C] - Neoplasms [C04]
Gender: Male. Age: 18-64 years, 65+ years. Enrolment: 140.
Status: Ended. Start date (EU): 2021-02-12. End date (EU): 2026-04-16. Decision date: 2024-04-09. Results received: No. Last updated: 2026-02-05.

Condition(s): OligoRecurrent prostate cancer
Product: BAY 1841788

Primary endpoint: Metastasis-free survival
Endpoint(s): Clinical progression-free survival, Biochemical relapse-free survival, Time to next systemic therapy, Castrate resistant-free survival, Prostate cancer-specific survival, Overall survival, Acute and late toxicity, Quality of life

Source: https://euclinicaltrials.eu/ctis-public/view/2024-511140-37-00